EU clinical trial 2024-516542-19-00: Searching simple biomarkers to phenotype type 2 diabetic patients and personalize their treatment
Protocol code: BioPhenoT2D
Sponsor: Fondazione Policlinico Universitario Agostino Gemelli IRCCS (Hospital/Clinic/Other health care facility). Phase: Therapeutic use (Phase IV). Countries: Italy (ongoing, recruiting).
Therapeutic area(s): Phenomena and Processes [G] - Metabolism [G03]; Diseases [C] - Nutritional and Metabolic Diseases [C18]
Gender: Female, Male. Age: 18-64 years, 65+ years. Enrolment: 148.
Status: Ongoing, recruiting. Start date (EU): 2025-07-08. Decision date: 2024-10-09. Results received: No. Last updated: 2026-04-27.

Condition(s): type 2 diabetes
Product: SEMAGLUTIDE, SEMAGLUTIDE, INSULIN GLARGINE, DAPAGLIFLOZIN

Primary endpoint: To assess the differential effects of treatment with semaglutide vs dapagliflozin on metabolic compensation and beta-cell function – measured through glycated hemoglobin (HbA1c)
Endpoint(s): To verify the ability of biomarkers to offer a signature for patients’ phenotyping even after treatment with dapagliflozin or semaglutide, To verify the ability of biomarkers to guide the more appropriate choice between dapagliflozin or semaglutide treatments in well-distinguished phenotypes of diabetic patients

Source: https://euclinicaltrials.eu/ctis-public/view/2024-516542-19-00